EU clinical trial 2023-507052-69-00: A Long-term Extension of the ARGX-117-2002 Trial to Evaluate the Long-term Safety and Tolerability, Efficacy, Pharmacodynamics, Pharmacokinetics, and Immunogenicity of ARGX-117 in Adults With Multifocal Motor Neuropathy
Protocol code: ARGX-117-2003
Sponsor: Argenx (Pharmaceutical company). Phase: Therapeutic exploratory (Phase II). Countries: Austria (ongoing, recruitment ended), Poland (ongoing, recruitment ended), France (ongoing, recruitment ended), Germany (ongoing, recruitment ended), Spain (ongoing, recruitment ended), Belgium (ongoing, recruitment ended), Netherlands (ongoing, recruitment ended), Italy (ongoing, recruitment ended).
Therapeutic area(s): Diseases [C] - Nervous System Diseases [C10]
Gender: Female, Male. Age: 18-64 years, 65+ years. Enrolment: 34.
Status: Ongoing, recruitment ended. Start date (EU): 2023-03-29. Decision date: 2024-02-06. Results received: No. Last updated: 2026-02-27.
Decision dates by country: NL: 2024-02-06, DE: 2024-02-08, BE: 2024-02-07, ES: 2024-02-14, PL: 2024-02-08, AT: 2024-03-07, FR: 2024-02-12, IT: 2024-02-09

Condition(s): Multifocal Motor Neuropathy
Product: Placebo to ARGX-117 IV, ARGX-117, ARGX-117

Primary endpoint: Safety outcomes based on AE monitoring and other safety assessments (clinical laboratory tests)
Endpoint(s): 1. Modified Medical Research Council (mMRC) − Value and change from baseline in the mMRC-10 sum score − Proportion of participants showing a deterioration of at least 2 points in mMRC-10 sum score − Value and change from baseline in the mMRC-14 sum score − Proportion of participants showing a deterioration of at least 2 points in the mMRC-14 sum score, − Value and change from baseline in the average score of the 2 most important muscle groups as assessed by the mMRC-14 sum score, 2. Grip strength (GS) − Values, change, and percent change from baseline in GS − Proportion of participants with a decline of >30% in GS, 3. Values and change from baseline in the Rasch-built overall disability scale for MMN (MMN‐RODS), 4. Values, change, and percentage change from baseline in the average time for the upper extremity (arm and hand) function (9-Hole Peg Test [9-HPT], or timed pegboard test), 5. Proportion of participants by level of severity on each dimension of EQ-5D-5L, 6. Value and change from baseline in EQ-5D-5L visual analog scale (VAS), 7. Values and change from baseline in the Chronic Acquired Polyneuropathy Patient-Reported Index (CAP-PRI), 8. Values and change from baseline in the 9-item Fatigue Severity Scale (FSS), 9. Values of the Patient Global Impression of Change (PGIC) scale, 10. Proportion of participants by level of severity of MMN as assessed by the Patient Global Impression of Severity (PGIS), 11. Values for work-related and household chore activities of the Health-Related Productivity Questionnaire (HRPQ) at each visit: − Hours lost because of absenteeism − Hours lost because of presenteeism, − Total hours lost − Percent of scheduled hours lost because of absenteeism − Percent of scheduled hours lost because of presenteeism − Percent of scheduled hours lost in total, 12. Serum concentrations and PK parameters for ARGX-117, 13.Values and change from baseline in free C2, total C2, and functional complement activity (CH50) over time, 14. Incidence and prevalence of antidrug antibodies (ADA) against ARGX-117

Source: https://euclinicaltrials.eu/ctis-public/view/2023-507052-69-00